EU clinical trial 2023-508258-24-00: Phase II Study to Assess the Efficacy of Niraparib Rechallenge after Surgery in Ovarian Cancer Patients with Oligometastatic Progression -The ANALLISA study-
Protocol code: MEDOPP557
Sponsor: Medica Scientia Innovation Research S.L. (Pharmaceutical company). Phase: Therapeutic exploratory (Phase II). Countries: Spain (ongoing, recruiting).
Therapeutic area(s): Diseases [C] - Neoplasms [C04]
Gender: Female. Age: 18-64 years, 65+ years. Enrolment: 30.
Status: Ongoing, recruiting. Start date (EU): 2024-09-12. Decision date: 2024-06-06. Results received: No. Last updated: 2026-06-01.

Condition(s): Ovarian cancer (OC) with oligometastatic progression (OMP).

Primary endpoint: PFS is defined as the period of time from niraparib treatment initiation until the subsequent disease progression or death, whichever occurs first, as determined locally by the investigator through the use of Response Evaluation Criteria in Solid Tumors Version 1.1 (RECIST v.1.1).
Endpoint(s): PFS by biomarker status is defined as the period of time from niraparib treatment initiation until the subsequent disease progression or death, whichever occurs first, as determined locally by the investigator through the use of RECIST v.1.1, in patients’ subgroups., PFS by CA 125 is defined as the time from treatment initiation until disease progression or death, whichever occurs first, as determined locally by the investigator using Gynecologic Cancer Intergroup (GCIC) criteria for CA 125 biomarker., PFS2 is defined as the time from treatment initiation to the earliest progression event after that used for the primary variable PFS, or date of death as determined locally by the investigator using RECIST v.1.1., TFST is defined as the time from the date of treatment initiation to the earliest date of anti-cancer therapy start date following study treatment discontinuation, or death., OS is defined as the period from treatment initiation to death from any cause, as determined locally by the investigator., Number of AEs, SAEs and SUSARs according to the CTCAE v.5.0.

Source: https://euclinicaltrials.eu/ctis-public/view/2023-508258-24-00